EU clinical trial 2024-519641-30-00: Safety, tolerance and antiretroviral activity of dasatinib: a pilot clinical trial in patients with recent HIV-1 infection
Protocol code: DASAHIVCURE
Sponsor: Fundacio De Recerca Clinic Barcelona-Institut D’Investigacions Biomediques August Pi I Sunyer (Laboratory/Research/Testing facility). Phase: Therapeutic exploratory (Phase II). Countries: Spain (ongoing, recruitment ended).
Therapeutic area(s): Diseases [C] - Virus Diseases [C02]
Gender: Female, Male. Age: 18-64 years. Enrolment: 24.
Status: Ongoing, recruitment ended. Start date (EU): 2026-01-26. Decision date: 2024-12-11. Results received: No. Last updated: 2024-12-11.

Condition(s): Asymptomatic patients with recent HIV-1 infection
Product: DASATINIB, Placebo

Primary endpoint: The primary endpoint of the study is to assess the safety and tolerability of dasatinib with and without antiretroviral therapy using the incidence of AA.
Endpoint(s): Immunological endpoints: -immune recovery (CD4 subpopulation levels). -inflammatory markers (ultra-sensitive CRP, IL6, TNF alpha) -immune activation (CD4/CD8, CD25, CD69, CD38, HLA-DR+) -bacterial translocation (rsCD163) -levels of NK-mediated cytotoxic activity (NK phenotyping and in vitro replication inhibition tests)., Virological endpoints: -decline in HIV viral load prior to ART initiation (4 weeks of dasatinib monotherapy) -impact on the viral reservoir (integrated DNA, genetically intact virus, residual and induced viral replication and determination of integration sites) -SAMHD1 phosphorylation levels, Senescence endpoints: -Expression in PBLs of beta-galactosidase, Bcl-2, Histone H2A, p16 and CD87.

Source: https://euclinicaltrials.eu/ctis-public/view/2024-519641-30-00